EU clinical trial 2023-509800-14-00: A clinical study to test the safety (any good or bad effects) of CC-90011 in combination with standard of care (cisplatin and etoposide), on how long the drug can stay in the body and if it can control the disease of people diagnosed with extensive small cell lung cancer and have not had any previous treatment for the disease. CC-90011, single agent, will be also given in consolidation after completion of the 4 to 6 cycles of chemotherapy
Protocol code: CC-90011-SCLC-001
Sponsor: Celgene Corp. (Pharmaceutical company). Phase: Human Pharmacology (Phase I)- Other. Countries: Spain (ended), Italy (ended).
Therapeutic area(s): Diseases [C] - Neoplasms [C04]
Gender: Female, Male. Age: 18-64 years, 65+ years. Enrolment: 66.
Status: Ended. Start date (EU): 2019-02-25. End date (EU): 2024-07-16. End date: 2024-07-17. Decision date: 2024-01-15. Results received: No. Last updated: 2024-05-30.
Decision dates by country: IT: 2024-02-19, ES: 2024-01-15

Condition(s): extensive stage small cell lung cancer

Source: https://euclinicaltrials.eu/ctis-public/view/2023-509800-14-00